EU clinical trial 2023-504673-20-00: A Phase 2b Multicenter, Randomized, Placebo-Controlled, Dose-Ranging Study to Evaluate the Efficacy and Safety of JNJ-77242113 for the Treatment of Moderately to Severely Active Ulcerative Colitis
Protocol code: 77242113UCO2001
Sponsor: Janssen - Cilag International (Pharmaceutical company). Phase: Therapeutic exploratory (Phase II). Countries: Czechia (ended), Spain (ended), Poland (ended), France (ended), Belgium (ended), Hungary (ended), Italy (ended), Germany (ended), Romania (ended).
Therapeutic area(s): Diseases [C] - Digestive System Diseases [C06]
Gender: Female, Male. Age: 18-64 years, 65+ years. Enrolment: 102.
Status: Ended. Start date (EU): 2023-12-06. End date (EU): 2025-12-22. End date: 2026-01-05. Decision date: 2023-11-27. Results received: No. Last updated: 2025-07-31.
Decision dates by country: DE: 2023-12-04, BE: 2023-11-27, RO: 2023-11-29, CZ: 2023-11-28, FR: 2023-12-04, IT: 2023-12-01, PL: 2023-11-30, ES: 2023-11-29, HU: 2023-11-30

Condition(s): Ulcerative Colitis
Product: MERCAPTOPURINE, Film-Coated Tablet without JNJ-77242113, JNJ-77242113, AZATHIOPRINE, METHOTREXATE, JNJ-77242113

Primary endpoint: Clinical response at Week 12

Source: https://euclinicaltrials.eu/ctis-public/view/2023-504673-20-00